EU clinical trial 2024-514976-41-00: GREAT; GRoningen Early-PD Ambroxol Treatment Trial
Protocol code: NL77347.042.22
Sponsor: Universitair Medisch Centrum Groningen (Hospital/Clinic/Other health care facility). Phase: Therapeutic exploratory (Phase II). Countries: Netherlands (ongoing, recruiting).
Therapeutic area(s): Diseases [C] - Nervous System Diseases [C10]
Gender: Female, Male. Age: 18-64 years, 65+ years. Enrolment: 80.
Status: Ongoing, recruiting. Start date (EU): 2024-09-23. Decision date: 2024-09-23. Results received: No. Last updated: 2024-09-23.

Condition(s): Parkinson's disease
Product: AMBROXOL, Microcrystalline cellulose

Primary endpoint: Comparison of MDS-UPDRS part III motor subscale in the practically defined OFF medication state at 60 weeks
Endpoint(s): Safety and tolerability by examination of adverse events, F-DOPA PET, MRI, Montreal Cognitive Assessment (MoCA), Non-Motor Symptoms scale (NMSS), Parkinson’s Disease Quality of life questionnaire with 39 items (PDQ-39), GCase activity measuring sphinglolipids in PBMCs and plasma

Source: https://euclinicaltrials.eu/ctis-public/view/2024-514976-41-00